EU clinical trial 2022-502385-24-00: (22292) Randomized, non-blinded, two-way crossover study to assess bioequivalence between finerenone 2 x 20 mg tablets and 1 x 40 mg tablet in healthy male adult participants
Protocol code: 22292
Sponsor: Bayer AG (Pharmaceutical company). Phase: Human Pharmacology (Phase I)- Bioequivalence Study. Countries: Germany (ended).
Therapeutic area(s): Diseases [C] - Cardiovascular Diseases [C14]
Gender: Male. Age: 18-64 years. Enrolment: 60.
Status: Ended. Start date (EU): 2023-04-27. End date (EU): 2023-07-28. Decision date: 2023-03-30. Results received: Yes. Last updated: 2023-03-30.

Condition(s): Heart failure with left ventricular ejection fraction ≥40%
Product: BAY 94-8862, Finerenone

Primary endpoint: Cmax for plasma finerenone concentration, AUC(0-tlast) for plasma finerenone concentration
Endpoint(s): Number of subjects with treatment-emergent adverse events (TEAEs)

Source: https://euclinicaltrials.eu/ctis-public/view/2022-502385-24-00